EU clinical trial 2024-517677-25-00: COSENSE-1: A feasibility study for using a functional precision medicine platform to select oxaliplatin-based versus irinotecan-based chemotherapy regimens for patients with metastatic colorectal cancer
Sponsor: St. Olavs Hospital HF (Hospital/Clinic/Other health care facility). Phase: Therapeutic exploratory (Phase II). Countries: Norway (ongoing, recruiting).
Therapeutic area(s): Diseases [C] - Neoplasms [C04]
Gender: Female, Male. Age: 18-64 years, 65+ years. Enrolment: 148.
Status: Ongoing, recruiting. Start date (EU): 2025-05-07. Decision date: 2024-12-18. Results received: No. Last updated: 2026-01-30.

Condition(s): MSS/pMMR metastatic colorectal cancer
Product: Oxaliplatin Fresenius Kabi, Irinotecan Fresenius Kabi

Primary endpoint: The rate of generating valid tumouroid response reports (valid is defined as a fper patienold-change growth in untreated controls of > 1, registered on day 5, 6, 7 or 8 and normalised with resepect to day 0 or 1): a) t included in the trial and b) per patient with obtained tumour samples, and 2) the time from referral to start of allocated treatment., What is the time from referral to start of allocated treatment
Endpoint(s): Response Rates (RR) including ORR, according to RECIST v1.1. criteria, Overall Survival (OS), Progression Free Survival (PFS), defined as the time from starting first-line treatment to the time of documentation of PD according to RECIST on active therapy, determined failure of treatment strategy or death, Progression Free Survival Rate at 6 months, Disease Control Rate (DCR) assessed with RECIST v1.1, Clinical Benefit Rate (CBR), defined as the percentage of patients who had a complete response, partial response, or had stable disease for 6 months or more, Toxicity graded with the CTCAE v.5.0: incidence of grade 3-5 adverse events

Source: https://euclinicaltrials.eu/ctis-public/view/2024-517677-25-00